EU clinical trial 2023-505296-72-00: A Randomized, Double-Blind, Placebo-Controlled, Parallel, 4-Arm Dose Ranging Study of the Safety and Efficacy of Nalbuphine Extended-Release Tablets (NAL ER) for the Treatment of Cough in Idiopathic Pulmonary Fibrosis (IPF)
Protocol code: NAL03-202
Sponsor: Trevi Therapeutics Inc. (Pharmaceutical company). Phase: Therapeutic exploratory (Phase II). Countries: Germany (ended), Netherlands (ended), Italy (ended), Spain (ended), Poland (ended).
Therapeutic area(s): Diseases [C] - Respiratory Tract Diseases [C08]
Gender: Female, Male. Age: 18-64 years, 65+ years. Enrolment: 90.
Status: Ended. Start date (EU): 2023-12-12. End date (EU): 2025-04-23. End date: 2025-04-24. Decision date: 2023-11-29. Results received: Yes. Last updated: 2025-01-13.
Decision dates by country: PL: 2023-11-30, NL: 2023-11-30, ES: 2023-11-29, IT: 2023-11-29, DE: 2023-11-29

Condition(s): Idiopathic Pulmonary Fibrosis (IPF)
Product: Nalbuphine ER, Placebo - Nalbuphine ER, Nalbuphine ER

Primary endpoint: Relative change from Baseline in 24-hour cough frequency (coughs per hour) at Week 6 for NAL ER compared with placebo.
Endpoint(s): Relative change from Baseline in the E-RS:IPF Cough subscale at Week 6 for NAL ER compared with placebo., Adverse events, clinical laboratory assessments, vital signs, spirometry and physical examination summaries., Electrocardiogram (ECG) summaries [ECGs will be analyzed in a separate report]., Subjective Opiate Withdrawal Scale (SOWS) daily summaries for the 14 days following the last dose of investigational product., Relative change from Baseline in 24-hour cough frequency (coughs per hour) at Week 2, 4, and 6, for NAL ER compared with placebo., Proportion of responders with ≥30%, ≥50% and ≥75% reduction in the 24-hour cough frequency at Week 2, 4, and 6, for NAL ER compared with placebo., Relative change from Baseline in awake cough frequency (coughs per hour) Week 2, 4, and 6, for NAL ER compared with placebo., Relative change from Baseline in sleep cough frequency (coughs per hour) at Week 2, 4, and 6, for NAL ER compared with placebo., Change from Baseline in the E-RS:IPF Cough subscale at Week 1, 2, 3, 4, 5, and 6, for NAL ER compared with placebo., Proportion of E-RS:IPF Cough subscale responders, with response defined as at least a one category improvement at Week 1, 2, 3, 4, 5, and 6 for NAL ER compared with placebo., Change from Baseline in the E-RS:IPF total score, subdomain scores (IPF-Breathlessness, IPF-Cough, IPF-Sputum, and IPF-Chest Symptoms), and individual items at Week 1, 2, 3, 4, 5, and 6, for NAL ER compared with placebo., Change from Baseline in the CS-NRS at Week 1, 2, 3, 4, 5, and 6, for NAL ER compared with placebo., Change from Baseline in the LCQ total scores at Week 6, for NAL ER compared with placebo., Proportion of LCQ total score responders, with response defined as 1.3-point increase at Week 6 for NAL ER compared with placebo., Change from Baseline in the L-IPF at Week 6, for NAL ER compared with placebo (Impacts)., Change from Baseline in the EQ-5D-5L at Week 6, for NAL ER compared with placebo., Change from Baseline in the PGI-S Cough at Week 2, 4, and 6, for NAL ER compared with placebo., Change from Baseline in the PGI-S IPF at Week 2, 4, and 6, for NAL ER compared with placebo., Change from Baseline in the CGI-S at Week 6, for NAL ER compared with placebo., Change from Baseline in the L-IPF and its domains at Week 6, for NAL ER compared with placebo (Symptoms)., Change from Baseline in the LCQ domains and individual items at Week 6, for NAL ER compared with placebo., PGI-C Cough score at Week 2, 4, and 6 for NAL ER compared with placebo., Proportion of subjects with improvement by ≥1 and ≥2 categories, worsening by ≥1 and ≥2 categories, and no change on the PGI-C and PGI-S cough at each post-baseline timepoint for NAL ER compared with placebo., PGI-C IPF score at Week 2, 4, and 6 for NAL ER compared with placebo., Proportion of subjects with improvement by ≥1 and ≥2 categories, worsening by ≥1 and ≥2 categories, and no change on the PGI-C and PGI-S IPF at each post-baseline timepoint for NAL ER compared with placebo., CGI-C IPF score at Week 6 for NAL ER compared with placebo., Proportion of subjects: improvement by ≥1 and ≥2 categories, worsening by ≥1 and ≥2 categories, and no change on the CGI-C and CGI-S at each post-baseline timepoint for NAL ER compared with placebo.

Source: https://euclinicaltrials.eu/ctis-public/view/2023-505296-72-00